EU clinical trial 2023-508930-33-00: CRYOBI study - A multicenter phase 2 single-arm proof-of-concept trial assessing the efficacy and safety of Obinutuzumab in the treatment of non-infectious active cryoglobulinemia vasculitis refractory or intolerant to Rituximab
Protocol code: APHP230848
Sponsor: Assistance Publique Hopitaux De Paris (Hospital/Clinic/Other health care facility). Phase: Therapeutic exploratory (Phase II). Countries: France (ongoing, recruiting).
Therapeutic area(s): Diseases [C] - Immune System Diseases [C20]
Gender: Female, Male. Age: 18-64 years, 65+ years. Enrolment: 30.
Status: Ongoing, recruiting. Start date (EU): 2026-01-30. Decision date: 2025-10-02. Results received: No. Last updated: 2026-06-04.

Condition(s): Non-infectious active cryoglobulinemia vasculitis who are either refractory or intolerant to Rituximab
Product: Gazyvaro 1,000 mg concentrate for solution for infusion.

Primary endpoint: Complete clinical response of CV at 6 months. Complete remission of CV is defined as remission of all affected organs involved at baseline and with corticosteroid withdrawal in the absence of severe clinical relapse.
Endpoint(s): Frequency and severity of adverse clinical events at W12, W24 and W48, Rates of patients with complete clinical response with corticosteroid withdrawal (prednisone at 0 mg/day), partial response, and no clinical response at W12, W24 and W48 (See section 8.1), Rate of patients with complete renal remission at W12, W24 and W48 defined as proteinuria <0.5g/24h or proteinuria/creatininuria <50 mg/mmol, and improvement of GFR >20% if GFR <60 mL/min/1.73 m² at diagnosis or GFR > 60 mL/min/1.73 m² if GFR ≥60ml/min/1.73m² at diagnosis., Rate of patients without cryoglobulinemia at W12, W24 and W48, Rate of patients without rheumatoid factor activity at W12, W24 and W48, Rate of patients with normal C4 complement level at W12, W24 and W48, Rate of patients with early treatment failure defined as the absence of clinical response at W4, Cumulative incidence of clinical relapse (severe or non-severe) defined by reappearance of a manifestation attributable to cryoglobulinemia vasculitis from baseline to the end of follow-up, Cumulative incidence of severe clinical relapse from baseline to the end of follow-up, Cumulative incidence of mild or moderate clinical relapse from baseline to the end of follow up, Cumulative dose of prednisone at W24 and at W48., BVAS activity score variation from baseline to W12, W24 and W48, Variation in physical and mental summary components of score SF-36 from baseline to W24 and to W48, Cumulative incidence of infections (severe or non-severe) from baseline to W48, Cumulative incidence of severe infections from baseline to W48, Cumulative incidence of non-severe infections from baseline to W48, Cumulative incidence of non-infectious complications (cancer, lymphoma, cardiovascular event: stroke, myocardial infarction, renal replacement, …) from baseline to W48, Variation of gammaglobulin and of CD19+ B cells levels from baseline to W12, W24 and W48, Overall survival, from baseline to the end of follow-up

Source: https://euclinicaltrials.eu/ctis-public/view/2023-508930-33-00